EU clinical trial 2024-516645-39-01: Applying Mysimba in patients with weight regain after bariatric surgery
Sponsor: Zuyderland Medisch Centrum Stichting (Hospital/Clinic/Other health care facility). Phase: Phase III and phase IV (Integrated). Countries: Netherlands (authorised, recruitment pending).
Therapeutic area(s): Diseases [C] - Digestive System Diseases [C06]; Diseases [C] - Nutritional and Metabolic Diseases [C18]
Gender: Female, Male. Age: 18-64 years, 65+ years. Enrolment: 157.
Status: Authorised, recruitment pending. Decision date: 2025-01-17. Results received: No. Last updated: 2025-01-17.

Condition(s): Obesity, Obesity Surgery
Product: Mysimba 8 mg/90 mg prolonged-release tablets

Primary endpoint: The primary objective is to study the effect of naltrexone/bupropion in combination with the BOT module on successful weight loss (>5% weight loss) after 22 weeks compared with the regular BOT module alone, in patients with weight regain after bariatric surgery. Assessment of bodyweight is standard part of treatment.

Source: https://euclinicaltrials.eu/ctis-public/view/2024-516645-39-01